EU clinical trial 2024-514767-26-00: Combining drug-eluting bead chemoembolization and radioembolization for treatment of colorectal liver metastases: DEBIR90Y study
Protocol code: NL66938.041.19
Sponsor: Universitair Medisch Centrum Utrecht (Hospital/Clinic/Other health care facility). Phase: Human Pharmacology (Phase I)- Other. Countries: Netherlands (ended).
Therapeutic area(s): Diseases [C] - Neoplasms [C04]
Gender: Female, Male. Age: 18-64 years, 65+ years. Enrolment: 15.
Status: Ended. Start date (EU): 2019-10-11. End date (EU): 2025-01-27. Decision date: 2024-08-22. Results received: No. Last updated: 2024-08-22.

Condition(s): colorectal liver metastases

Source: https://euclinicaltrials.eu/ctis-public/view/2024-514767-26-00